EU clinical trial 2024-518465-10-00: A Phase 2 Study to Evaluate the Safety and Efficacy of Atacicept in Multiple Autoimmune Glomerular Diseases (PIONEER)
Protocol code: VT-001-0060
Sponsor: Vera Therapeutics Inc. (Pharmaceutical company). Phase: Therapeutic exploratory (Phase II). Countries: Germany (ongoing, recruiting), France (authorised, recruiting), Italy (ongoing, recruiting), Spain (ongoing, recruiting), Poland (ongoing, recruiting), Belgium (ongoing, recruiting).
Therapeutic area(s): Diseases [C] - Pathological Conditions, Signs and Symptoms [C23]
Gender: Female, Male. Age: 0-17 years, 18-64 years, 65+ years. Enrolment: 124.
Start date (EU): 2025-12-12. Decision date: 2025-09-08. Results received: No. Last updated: 2026-08-07.
Decision dates by country: ES: 2025-11-12, FR: 2025-09-26, DE: 2025-09-09, PL: 2025-09-12, IT: 2025-11-11, BE: 2025-11-10

Condition(s): Multiple Autoimmune Glomerular Diseases
Product: Atacicept Autoinjector Combination, Atacicept

Primary endpoint: AE profile and results of routine clinical and laboratory tests through Week 52, Change from baseline in UPCR at Week 36, Serum concentration of atacicept through Week 24 (pediatric cohorts IgAN-6, IgAN-8, and IgAN-9)
Endpoint(s): Changes from baseline in eGFR at Weeks 36 and 52, Changes from baseline in Gd-IgA1 at Weeks 36 and 52 (IgAN), or anti-PLA2R antibody titer at Weeks 4, 8, 12, 36, and 52 (pMN), or anti-nephrin (NS) antibody levels at Weeks 4, 8, 12, 36 and 52, Proportion of participants achieving proteinuria responses at Weeks 24, 36, and 52, Change from baseline in UPCR at Week 52 (IgAN cohorts), or Weeks 12, 24, and 52 (pMN and NS cohorts), Serum concentration of atacicept through Week 52, Change from baseline in PD biomarkers (serum IgG, IgA, IgM, BAFF and APRIL) levels throught Week 52

Source: https://euclinicaltrials.eu/ctis-public/view/2024-518465-10-00